EU clinical trial 2022-500676-59-00: Nivolumab in combination with cisplatin and 5-fluorouracil as induction therapy in children and adults with EBV-positive nasopharyngeal carcinoma
Protocol code: NPC-Nivo
Sponsor: GPOH gGmbH (Patient organisation/association). Phase: Therapeutic exploratory (Phase II). Countries: Germany (ongoing, recruiting).
Therapeutic area(s): Diseases [C] - Neoplasms [C04]
Gender: Female, Male. Age: 0-17 years, 18-64 years. Enrolment: 57.
Status: Ongoing, recruiting. Start date (EU): 2025-12-18. Decision date: 2022-08-08. Results received: No. Last updated: 2026-07-08.

Condition(s): EBV-positive nasopharyngeal carcinoma
Product: CARBOPLATIN, CISPLATIN, GEMCITABINE, NIVOLUMAB, FLUOROURACIL, INTERFERON BETA-1A

Primary endpoint: Complete remission rate (CRR): defined as the proportion of subjects achieving a complete response on MRI and PET/CT after induction chemotherapy with 5-fluorouracil and cisplatin in combination with Nivolumab according to RECIST 1.1 criteria
Endpoint(s): Event-free survival (EFS), Overall survival (OS), Safety and tolerability: adverse events (AEs), serious adverse events (SAEs), Efficacy based on PD-L1 expression in tumor tissue

Source: https://euclinicaltrials.eu/ctis-public/view/2022-500676-59-00